EU clinical trial 2023-506312-41-00: A Phase 1/2 Open-label, Rolling-arm, Umbrella Platform Design of Investigational Agents With or Without Pembrolizumab or Pembrolizumab Alone in Participants with Melanoma (KEYMAKER-U02): Substudy 02A
Protocol code: MK-3475-02A
Sponsor: Merck Sharp & Dohme LLC (Pharmaceutical company). Phase: Phase I and Phase II (Integrated)- Other. Countries: France (ended), Italy (ended).
Therapeutic area(s): Diseases [C] - Neoplasms [C04]
Gender: Female, Male. Age: 18-64 years, 65+ years. Enrolment: 58.
Status: Ended. Start date (EU): 2020-07-30. End date (EU): 2025-08-22. End date: 2025-08-25. Decision date: 2023-12-04. Results received: Yes. Last updated: 2025-09-01.
Decision dates by country: FR: 2023-12-04, IT: 2023-12-14

Condition(s): PD-1 refractory melanoma
Product: Lenvatinib, quavonlimab, TRETINOIN, KEYTRUDA 25 mg/mL concentrate for solution for infusion, Lenvatinib, vibostolimab

Primary endpoint: Percentage of participants who experience an adverse event (AE), Percentage of participants who discontinue study treatment due to an AE, Objective response rate (ORR) per Response Evaluation Criteria in Solid Tumors 1.1 (RECIST 1.1)
Endpoint(s): Duration of response (DOR) per RECIST 1.1

Source: https://euclinicaltrials.eu/ctis-public/view/2023-506312-41-00